EU clinical trial 2022-501505-13-00: INCA 32459-101: A Phase 1, Open-Label, Multicenter Study of INCA32459 in Participants With Select Advanced Malignancies
Protocol code: INCA 32459-101
Sponsor: Incyte Corp. (Pharmaceutical company). Phase: Human Pharmacology (Phase I)- First administration to humans. Countries: Belgium (ended), Spain (ended), Italy (ended), France (ended).
Therapeutic area(s): Diseases [C] - Neoplasms [C04]
Gender: Female, Male. Age: 18-64 years, 65+ years. Enrolment: 140.
Status: Ended. Start date (EU): 2023-03-31. End date (EU): 2025-09-23. End date: 2025-10-13. Decision date: 2023-02-17. Results received: No. Last updated: 2025-01-13.
Decision dates by country: IT: 2024-02-20, FR: 2024-04-08, BE: 2023-03-24, ES: 2023-02-17

Condition(s): Metastatic melanoma, Neoplasm malignant, Squamous cell carcinoma of head and neck, Diffuse large B-cell lymphoma, Primary mediastinal large B-cell lymphoma

Source: https://euclinicaltrials.eu/ctis-public/view/2022-501505-13-00